EU clinical trial 2023-508312-39-00: Safety, Tolerability, Pharmacokinetics, and Pharmacodynamics of AB-101 Following Oral Administration in Healthy and Chronic Hepatitis B Subjects
Protocol code: AB-101-001
Sponsor: Arbutus Biopharma Inc. (Pharmaceutical company). Phase: Human Pharmacology (Phase I)- First administration to humans. Countries: Romania (ended), Italy (ended), Bulgaria (ended).
Therapeutic area(s): Diseases [C] - Virus Diseases [C02]
Gender: Female, Male. Age: 18-64 years. Enrolment: 27.
Status: Ended. Start date (EU): 2024-12-13. End date (EU): 2025-11-25. End date: 2025-11-26. Decision date: 2024-12-04. Results received: No. Last updated: 2025-08-27.
Decision dates by country: BG: 2024-12-09, IT: 2024-12-04, RO: 2024-12-09

Condition(s): Chronic hepatitis B virus Infection

Source: https://euclinicaltrials.eu/ctis-public/view/2023-508312-39-00